EU clinical trial 2024-513584-77-00: A Phase 2a, Double-Blind, Randomized, Active Controlled, Parallel Group Study Evaluating the Efficacy, Safety, and Tolerability of Bezafibrate Administered in Combination with Obeticholic Acid in Subjects with Primary Biliary Cholangitis
Protocol code: 747-214
Sponsor: Intercept Pharmaceuticals Inc. (Pharmaceutical company). Phase: Therapeutic exploratory (Phase II). Countries: Italy (ended).
Therapeutic area(s): Phenomena and Processes [G] - Digestive System and Oral Physiological Phenomena [G10]
Gender: Female, Male. Age: 18-64 years, 65+ years. Enrolment: 5.
Status: Ended. Start date (EU): 2023-03-09. End date (EU): 2025-08-06. End date: 2025-09-01. Decision date: 2024-07-29. Results received: Yes. Last updated: 2025-03-24.

Condition(s): Primary biliary cholangitis
Product: Ocaliva 5 mg film-coated tablets

Primary endpoint: The primary efficacy endpoint is the change in ALP from baseline to Week 12 in the DB Phase
Endpoint(s): Safety and tolerability, The response rates of ≥10%, ≥20%, ≥30%, and ≥40% reduction from baseline at Week 12, and normalization rates of ALP at Week 12, Normalization rates at Week 12 of GGT, ALT, AST, total and conjugated bilirubin, and lipid panel, Change from baseline to Week 12 in GGT, ALT, AST, ALP and total and conjugated bilirubin, and lipid panel, Change from baseline to Week 12 in 7α-hydroxy-4-cholesten-3-one (C4) and bile acids

Source: https://euclinicaltrials.eu/ctis-public/view/2024-513584-77-00